EU clinical trial 2024-517215-67-00: IFM2020-05-BENEFIT-Multicenter Open label Phase 3 study of Isatuximab plus Lenalidomide and Dexamethasone with/without Bortezomib in the Treatment of Newly diagnosed Non-Frail transplant Ineligible Multiple Myeloma elderly patients (≥ 65; < 80 years).
Protocol code: IFM2020-05-BENEFIT
Sponsor: Centre Hospitalier Universitaire De Poitiers (Hospital/Clinic/Other health care facility). Phase: Therapeutic confirmatory (Phase III). Countries: France (ongoing, recruitment ended).
Therapeutic area(s): Diseases [C] - Hemic and Lymphatic Diseases [C15]
Gender: Female, Male. Age: 65+ years. Enrolment: 270.
Status: Ongoing, recruitment ended. Start date (EU): 2021-06-11. Decision date: 2024-10-18. Results received: No. Last updated: 2026-02-06.

Condition(s): Newly diagnosed Non-Frail transplant Ineligible Multiple Myeloma elderly patients
Product: SARCLISA 20mg/mL concentrate for solution for infusion., DEXAMETHASONE, DEXAMETHASONE, VELCADE 3.5 mg powder for solution for injection, Revlimid 25 mg hard capsules, DEXAMETHASONE, DEXAMETHASONE

Primary endpoint: MRD negative rate: defined as the proportion of patients with MRD negative in bone marrow aspirate (< 10-5) at 18 months
Endpoint(s): Clinical and laboratory parameters, adverse events, and vital signs according to CTCAE 5.0, Overall Response rate defined as the proportion of patients with best overall response /VGPR or better rate defined as the proportion of patients with CR and VGPR /Duration of response defined as the time from first response to the date of first documentation of progression/Time to first response-time to best response defined as the time from randomization to the date of first documentation /Rate of primary refractory: defined as the proportion of patients with SD or DP, MRD rate: defined as the proportion of patients with MRD in bone marrow aspirate (< 10-5) at 12 months, and yearly, Sustained MRD rate: defined as the proportion of patients with sustained MRD in bone marrow aspirate (< 10-5) between 2 evaluations as determined in the protocol., Rate of loss of MRD at 10-5: defined as the proportion of patients with MRD negative at 10-5 who lose the MRD negative status at the next evaluation., Time to reach MRD negative rate at 10-5: defined as the time from randomization to the date of the first MRD negative rate at 10-5 Time to lose MRD negative rate at 10-5: defined as the time from randomization or from the date of MRD negative at 10-5 to the date of MRD positive at 10-5, OS=the time from the date of randomization to death TTP=the time from randomization to the date of 1er documentation of DP PFS= the time from randomization until the earliest date of documented DP or death TTNT= as time from discontinuation from treatment to the date of next myeloma therapy in patients that had progression and are alive. EFS=as permanent discontinuation of study treatment as a whole, death or progression ., To determine Response, MRD rate and survival rate in either arm with regards to genomic abnormalities in the bone marrow tumor plasma cells, All endpoints of efficacy of originator and generic bortezomib will be studying statistically, All endpoints of efficacy of originator and generic lenalidomid will be studying statistically, All endpoints of apixaban exposure will be studying statistically, All endpoints of correlation between apixaban plasma level and myeloma treatments will be studying statistically, The outcome measure are: - Adverse events (arm A vs B) - Overall management of the Velcade therapy within the frame of BENEFIT - Cost of the subsequent line of therapy (in both arms) - Progression in arm B of patients having relapsed before C19 (post C19 no more Velcade)Quality-adjusted life years (QALYs).

Source: https://euclinicaltrials.eu/ctis-public/view/2024-517215-67-00